EU clinical trial 2024-515421-28-00: A study to learn how different amounts of the study medicine called PF-07941944 are tolerated in the body of healthy adults.
Protocol code: C5961001
Sponsor: Pfizer Inc. (Pharmaceutical company). Phase: Human Pharmacology (Phase I)- First administration to humans. Countries: Belgium (ended).
Therapeutic area(s): Diseases [C] - Virus Diseases [C02]
Gender: Female, Male. Age: 18-64 years. Enrolment: 66.
Status: Ended. Start date (EU): 2024-11-28. End date (EU): 2025-06-19. End date: 2025-06-20. Decision date: 2024-11-27. Results received: No. Last updated: 2024-11-27.

Condition(s): RSV (Respiratory Syncytial Virus)

Source: https://euclinicaltrials.eu/ctis-public/view/2024-515421-28-00